EU clinical trial 2024-515057-19-00: The efficacy and safety of Metoprolol as add-on treatment to standard of care in preventing cardiomyopathy in patients with Duchenne Muscular Dystrophy aged 8-17 years. A randomized, double-blind, placebo controlled study
Protocol code: NBK154/1/2020
Sponsor: Medical University Of Gdansk (Educational Institution). Phase: Therapeutic confirmatory (Phase III). Countries: Poland (ended).
Therapeutic area(s): Diseases [C] - Cardiovascular Diseases [C14]
Gender: Female, Male. Age: 0-17 years, 18-64 years. Enrolment: 144.
Status: Ended. Start date (EU): 2021-07-12. End date (EU): 2025-10-06. Decision date: 2024-12-16. Results received: Yes. Last updated: 2024-12-16.

Condition(s): Duchenne muscular dystrophy; Cardiomyopathy; Tachycardia
Product: PL1, Betaloc ZOK 100, 95 mg, tabletki o przedłużonym uwalnianiu, Betaloc ZOK 25, 23,75 mg, tabletki o przedłużonym uwalnianiu, PL2

Primary endpoint: The primary endpoint is change in left ventricular ejection fraction (LVEF) by Teichholtz method (echocardiography), compared to baseline at Interim Analysis and Final Analysis.
Endpoint(s): • Disease Free Survival (DFS) i.e., the time to develop cardiomyopathy defined as Left Ventricular Ejection Fraction – (LVEF) <55% by echocardiography Teichholtz method. • prevalence of patients with cardiomyopathy defined as Left Ventricular Ejection Fraction – (LVEF) <55% by echocardiography Teichholtz method • Disease Free Survival (DFS) i.e., the time to develop clinically evident Heart Failure (HF)

Source: https://euclinicaltrials.eu/ctis-public/view/2024-515057-19-00